EU clinical trial 2024-512532-30-00: Phase Ib Safety, Tolerability and Pharmacokinetic Study of Subcutaneously Administered HER-096 in Healthy Volunteer Subjects and Patients with Parkinson’s Disease
Protocol code: 14-XC-CL
Sponsor: Herantis Pharma Oyj (Pharmaceutical company). Phase: Human Pharmacology (Phase I)- Other. Countries: Finland (ended).
Therapeutic area(s): Diseases [C] - Nervous System Diseases [C10]
Gender: Female, Male. Age: 18-64 years, 65+ years. Enrolment: 40.
Status: Ended. Start date (EU): 2024-09-18. End date (EU): 2025-08-14. Decision date: 2024-09-03. Results received: No. Last updated: 2024-09-03.

Condition(s): Parkinson’s Disease

Source: https://euclinicaltrials.eu/ctis-public/view/2024-512532-30-00